EU clinical trial 2023-505739-12-01: A 52-week multi-center, randomized, double-blind, placebo controlled, basket study with an open-label extension to investigate the efficacy, safety, and tolerability of remibrutinib (LOU064) in Chronic Inducible Urticaria (CINDU) in adults inadequately controlled by H1-antihistamines
Protocol code: CLOU064M12301
Sponsor: Novartis Pharma AG (Pharmaceutical company). Phase: Therapeutic confirmatory (Phase III). Countries: Romania (ended), Slovakia (ongoing, recruitment ended), Poland (ongoing, recruitment ended), Portugal (ongoing, recruitment ended), France (ongoing, recruitment ended), Hungary (ongoing, recruitment ended), Netherlands (ongoing, recruitment ended), Spain (ongoing, recruitment ended), Germany (ongoing, recruitment ended), Italy (ongoing, recruitment ended).
Therapeutic area(s): Diseases [C] - Immune System Diseases [C20]
Gender: Female, Male. Age: 18-64 years, 65+ years. Enrolment: 109.
Start date (EU): 2024-09-30. Decision date: 2024-08-26. Results received: No. Last updated: 2026-07-27.
Decision dates by country: NL: 2024-08-26, PL: 2024-08-30, IT: 2024-08-27, FR: 2024-08-26, RO: 2024-09-02, HU: 2024-09-02, PT: 2024-09-13, DE: 2024-08-27, ES: 2024-08-27, SK: 2024-08-27

Condition(s): Chronic Inducible Urticaria (CINDU)
Product: LOU064, Placebo to Remibrutinib (LOU064) XX mg film-coated tablet

Primary endpoint: ● Symptomatic dermographism; Proportion of participants with complete response to Total Fric Score (TFS) following the FricTest® 4.0 at Week 12 ● Cold urticaria: proportion of participants with complete response in Critical Temperature Threshold (CTT) following the TempTest® at Week 12. ● Cholinergic urticaria: proportion of participants with itch NRS=0 following the pulse-controlled ergometry test at Week 12
Endpoint(s): ● Symptomatic dermographism: Change from baseline in Total Fric Score (TFS) following the FricTest® at Week 12 ● Cold urticaria: Change from baseline in Critical temperature threshold (CTT) following the TempTest® at Week 12 ● Cholinergic urticaria: Change from baseline in itch NRS following the pulse-controlled ergometry test at Week 12, ● Cholinergic urticaria: Proportion of participants with Physician Global Assessment (PGA) of severity of hives = 0 following the pulse-controlled ergometry test at Week 12., ● Symptomatic dermographism: Proportion of participants with complete response to Total Fric Score (TFS) following the FricTest® at Week 24 ● Cold urticaria: Proportion of participants with complete response in Critical temperature Threshold (CTT) following the TempTest® at Week 24 ● Cholinergic urticaria: Proportion of participants with itch NRS=0 following the pulse-controlled ergometry test at Week 24, ● Symptomatic dermographism: Change from baseline in itch NRS following the FricTest® at Week 12 ● Cold urticaria: Change from baseline in itch NRS following the TempTest® at Week 12, ● Symptomatic dermographism: Proportion of participants with complete response in Total Fric score (TFS) following the FricTest® at Week 2 ● Cold urticaria: Proportion of participants with complete response in Critical temperature threshold (CTT) following the TempTest® at Week 2 ● Cholinergic urticaria: Proportion of participants with itch NRS=0 following the pulse-controlled ergometry test at Week 2, ● Symptomatic dermographism: Change from baseline in Total Fric Score (TFS) following the FricTest® at Week 2 ● Cold urticaria: Change from baseline in the Critical Temperature threshold (CTT) following the TempTest® at Week 2 ● Cholinergic urticaria: Change from baseline in itch NRS following the pulse-controlled ergometry test at Week 2, ● Symptomatic dermographism: Change from baseline in itch NRS following the FricTest® at Week 2 ● Cold urticaria: Change from baseline in itch NRS following the TempTest® at Week 2 ● Cholinergic urticaria: Proportion of participants with Physician Global assessment (PGA) of severity of hives=0 following the pulse-controlled ergometry test at Week 2, ● Change from baseline in the weekly most bothersome symptom NRS score on the USDD at Week 12 for each cohort, ● Proportion of participants with DLQI= 0-1 at Week 12 for each cohort, ● Safety endpoints for inducible urticaria subtypes will include but not be limited to: ● Occurrence of treatment emergent adverse events (AEs) ● Occurrence of treatment emergent serious adverse events (SAEs) ● Occurrence of treatment emergent adverse events of special interest (AESIs)

Source: https://euclinicaltrials.eu/ctis-public/view/2023-505739-12-01